EU clinical trial 2024-514967-25-00: PET imaging of tumors with strong desmoplastic reaction in pancreas, bile ducts, ventricle and ovaries by a novel tracer, 68Ga-FAPI-46 = Fibroblast Activation Protein Inhibitor
Protocol code: H035FAPI-PET
Sponsor: Karolinska University Hospital (Hospital/Clinic/Other health care facility). Phase: Therapeutic exploratory (Phase II). Countries: Sweden (ongoing, recruiting), Finland (ongoing, recruiting).
Therapeutic area(s): Analytical, Diagnostic and Therapeutic Techniques and Equipment [E] - Diagnosis [E01]
Gender: Female, Male. Age: 18-64 years, 65+ years. Enrolment: 425.
Status: Ongoing, recruiting. Start date (EU): 2024-07-03. Decision date: 2024-07-03. Results received: No. Last updated: 2026-04-10.
Decision dates by country: SE: 2024-07-03, FI: 2025-07-18

Condition(s): Cancer
Product: 68Ga-FAPI-46

Primary endpoint: Surgery with histopathological confirmation of diagnosis
Endpoint(s): To evaluate FAPI- PET/CT as a staging tool for all included cancer entities, the secondary endpoint variables will be assessed with the histopathological diagnosis as a refence standard for regional or distant lymph nodes and/or resected local or distant metastatic tumor tissue when present., To investigate the correlation between in-vivo uptake of FAPI and ex-vivo immunohistochemically determined biomarker (FAP, PDGFR-α, PDGFR-β and α-SMA) expression in the stroma of these tumors, postsurgical histopathological confirmation of diagnosis will be used for confirmation of tumor histology (benign and malignant)., Assessment of FAPI- PET/CT and stroma markers as prognostic factors in patients with these cancers will be performed by recording disease free survival (DFS) and overall survival OS at 1 – year, 2 – years and 5 – years clinical follow – ups continuously during the follow – up period of the study., 4. To investigate the difference in diagnostic accuracy of FAPI- PET/CT compared to conventional radiology performed according to clinical routine, either postsurgical histopathological or histopathological/cytological (in the case of tissue biopsy material) confirmation of diagnosis will be used as a reference standard for differential diagnosis between malignant and benign lesions as well as for N and M staging, To investigate the frequency of Adverse Events (AEs), Adverse Reactions (ARs), Serious Adverse Events (SAEs) and Suspected Unexpected Serious Adverse Reactions (SUSARs)

Source: https://euclinicaltrials.eu/ctis-public/view/2024-514967-25-00